EU clinical trial 2022-501220-14-00: Multicenter, open-label, phase 2 study of carboplatin plus mirvetuximab soravtansine followed by mirvetuximab soravtansine continuation in folate receptor-alpha positive, recurrent platinum sensitive, high-grade epithelial ovarian, primary peritoneal, or fallopian tube cancer following 1 prior line of platinum-based chemotherapy
Protocol code: IMGN853-0420
Sponsor: AbbVie Deutschland GmbH & Co. KG (Pharmaceutical company). Phase: Therapeutic exploratory (Phase II). Countries: Spain (ongoing, recruitment ended), Belgium (ongoing, recruitment ended), Ireland (ended).
Therapeutic area(s): Diseases [C] - Neoplasms [C04]
Gender: Female. Age: 18-64 years, 65+ years. Enrolment: 45.
Start date (EU): 2023-10-17. Decision date: 2023-04-26. Results received: No. Last updated: 2026-06-19.
Decision dates by country: IE: 2023-12-01, ES: 2023-04-26, BE: 2023-11-22

Condition(s): epithelial ovarian, primary peritoneal, or fallopian tube cancer
Product: Pred Forte 1% w/v, Eye Drops Suspension, Carboplatin 10 mg/ml Intravenous Infusion, Ribocarbo®-L 10 mg/ml – Konzentrat zur Herstellung einer Infusionslösung, Carboplatin Accord 10 mg/ml Konzentrat zur Herstellung einer Infusionslösung, Mirvetuximab Soravtansine

Primary endpoint: ORR following carboplatin plus MIRV combination as measured by the investigator and assessed according to Response Evaluation Criteria in Solid Tumors (RECIST) v1.1, defined as the proportion of confirmed responders among patients with FRα expression of ≥ 50% of tumor cells with PS2+ staining intensity who have measurable disease per RECIST v1.1 at inclusion
Endpoint(s): ORR, defined as the proportion of confirmed responders (CR or PR) following carboplatin plus MIRV combination, as measured by the investigator and assessed according to the RECIST v1.1, among patients with FRα expression of ≥ 25% of tumor cells with PS2+ staining intensity who have measurable disease per RECIST v1.1 at inclusion o ORR will also be measured by a BICR, as a sensitivity analysis, in the same patient population.

Source: https://euclinicaltrials.eu/ctis-public/view/2022-501220-14-00